EU clinical trial 2023-510183-12-00: Interventional, randomized, double-blind, parallel-group, placebo-controlled study to evaluate efficacy and safety of eptinezumab for the preventive treatment of migraine
Protocol code: 19140A
Sponsor: H. Lundbeck A/S (Pharmaceutical company). Phase: Therapeutic confirmatory (Phase III). Countries: Poland (ended), Slovakia (ended), Spain (ended).
Therapeutic area(s): Diseases [C] - Nervous System Diseases [C10]
Gender: Female, Male. Age: 18-64 years, 65+ years. Enrolment: 330.
Status: Ended. Start date (EU): 2021-07-05. End date (EU): 2025-01-22. End date: 2025-02-17. Decision date: 2024-04-08. Results received: Yes. Last updated: 2024-05-13.
Decision dates by country: ES: 2024-04-12, PL: 2024-04-12, SK: 2024-04-08

Condition(s): Chronic migraine
Product: VYEPTI 100 mg concentrate for solution for infusion

Primary endpoint: Change from baseline in the number of monthly migraine days (MMDs) Timepoint(s) of evaluation of this end point: Weeks 1-12
Endpoint(s): Response: ≥50% reduction from baseline in MMDs (Weeks 1-12), Response: ≥75% reduction from baseline in MMDs (Weeks 1-4), Response: ≥75% reduction from baseline in MMDs (Weeks 1-12), Migraine rate on the day after dosing (Day 1)

Source: https://euclinicaltrials.eu/ctis-public/view/2023-510183-12-00